EU clinical trial 2025-522294-11-00: A Phase 2, Multicenter, Randomized, Double-Blind, Placebo-Controlled, Dose-Ranging Study of Nemolizumab in Adult Patients with Systemic Sclerosis, including a 52-Week Main Treatment Period and a 156-Week Extension Treatment Period
Protocol code: SPR207796
Sponsor: Galderma S.A. (Pharmaceutical company). Phase: Therapeutic exploratory (Phase II). Countries: Poland (authorised, recruiting), Italy (authorised, recruitment pending), Bulgaria (ongoing, recruiting), France (ongoing, recruiting), Greece (authorised, recruitment pending), Spain (authorised, recruiting), Croatia (authorised, recruiting).
Therapeutic area(s): Diseases [C] - Skin and Connective Tissue Diseases [C17]
Gender: Female, Male. Age: 18-64 years, 65+ years. Enrolment: 56.
Start date (EU): 2026-07-17. Decision date: 2026-06-17. Results received: No. Last updated: 2026-08-07.
Decision dates by country: BG: 2026-06-22, HR: 2026-06-19, FR: 2026-06-17, PL: 2026-06-18, ES: 2026-06-17, GR: 2026-07-27, IT: 2026-06-17

Condition(s): Systemic sclerosis
Product: Placebo Lyophilized Powder for Solution for Injection, Nemluvio 30 mg powder and solvent for solution for injection in pre-filled pen

Primary endpoint: Change from baseline (BL) in modified Rodnan Skin Score at week 52
Endpoint(s): Change from BL in forced vital capacity at week 52, Proportion of responders to the treatment based on the revised Composite Response Index in Systemic Sclerosis at week 52, Incidence and severity of treatment-emergent adverse events (TEAEs), treatment-emergent serious AEs (SAEs), treatment-emergent AEs of special interest (AESIs), significant SSc-related TEAEs, TEAEs leading to IP discontinuation, and TEAEs leading to study discontinuation., Incidence of abnormal vital signs; Incidence of abnormal laboratory parameters; Incidence of abnormal ECG findings; Incidence of abnormal weight change throughout the 52-week main treatment period, Incidence of abnormal vital signs; Incidence of abnormal laboratory parameters; Incidence of abnormal weight change the throughout 156-week extension treatment period, Nemolizumab serum concentrations. Detection and characterization of anti-drug antibodies

Source: https://euclinicaltrials.eu/ctis-public/view/2025-522294-11-00